EU clinical trial 2025-523286-23-00: Evaluation of a [68Ga] Ga-HER2 single domain antibody PET/CT for predicting pathological complete response (pCR) after neoadjuvant chemotherapy (NACT) in HER2-positive early breast cancer
Sponsor: Centre Henri Becquerel (Hospital/Clinic/Other health care facility). Phase: Phase I and Phase II (Integrated)- Other. Countries: France (ongoing, recruiting).
Therapeutic area(s): Not possible to specify
Gender: Female. Age: 18-64 years, 65+ years. Enrolment: 42.
Status: Ongoing, recruiting. Start date (EU): 2026-07-15. Decision date: 2026-01-26. Results received: No. Last updated: 2026-05-07.

Condition(s): Breast Cancer

Primary endpoint: The primary endpoint will evaluate the concordance rate between the response estimated by [⁶⁸Ga]Ga-NOTA-anti-HER2-sdAb PET-CT and the complete histological response (pCR) on the invasive component (ypT0/is ypN0).

Source: https://euclinicaltrials.eu/ctis-public/view/2025-523286-23-00